EU clinical trial 2024-516701-22-00: Reduction of SystemiC Inflammation after ischemic stroke by intravenous DNase administration (ReSCInD)
Protocol code: RESCIND-1-2023
Sponsor: Klinikum der Universitaet Muenchen AöR (Hospital/Clinic/Other health care facility). Phase: Therapeutic exploratory (Phase II). Countries: Germany (authorised, recruitment pending).
Therapeutic area(s): Diseases [C] - Nervous System Diseases [C10]
Gender: Female, Male. Age: 18-64 years, 65+ years. Enrolment: 36.
Status: Authorised, recruitment pending. Decision date: 2024-10-31. Results received: No. Last updated: 2026-04-23.

Condition(s): Reduction of SystemiC Inflammation after ischemic stroke by intravenous DNase administration
Product: Isotonische Kochsalzlösung, Pulmozyme 2.500 E./2,5 ml, Lösung für einen Vernebler

Primary endpoint: The primary endpoint, IL-1 β concentration in the blood within 24±6 hrs after symptom onset, will be analyzed in the full analysis set, which comes as close as possible to the IIT principle. A mixed linear regression model is calculated with the IL-1 β value (at 24±6hrs & 3 d) as the dependent variable, the randomized group, the IL-1 β value at baseline & the time point, the interaction of time + group, as independent variables and the patient as a random effect.
Endpoint(s): All secondary endpoints are analyzed descriptively, and differences between the two study arms are explored according to their level of measurement.

Source: https://euclinicaltrials.eu/ctis-public/view/2024-516701-22-00